EU clinical trial 2024-513395-18-00: EarLy extra Measles immunisation during a measles Outbreak (ELMO)
Protocol code: IIV-671
Sponsor: Rijksinstituut voor Volksgezondheid en Milieu (RIVM) (Hospital/Clinic/Other health care facility). Phase: Therapeutic use (Phase IV). Countries: Netherlands (authorised, recruitment pending).
Therapeutic area(s): Phenomena and Processes [G] - Immune system processes [G12]; Health Care [N] - Environment and Public Health [N06]; Diseases [C] - Virus Diseases [C02]
Gender: Female, Male. Age: 0-17 years. Enrolment: 155.
Status: Authorised, recruitment pending. Decision date: 2024-07-22. Results received: No. Last updated: 2026-06-11.

Condition(s): Healthy infants receiving a profylactic vaccine to prevent measles infection
Product: Nimenrix powder and solvent for solution for injection in pre-filled syringe Meningococcal groups A, C, W-135 and Y conjugate vaccine, M-M-RvaxPro powder and solvent for suspension for injection in pre-filled syringe Measles, mumps and rubella vaccine (live)

Primary endpoint: Measles specific virus neutralising antibody concentrations 4 weeks post MMR-0 immunisation
Endpoint(s): Measles specific maternal antibody concentrations prior to MMR-0 immunisation., Measles specific virus neutralising antibody concentrations prior to, 4 weeks post and 1 year post MMR-1 immunisation in MMR-0 immunised children and a control group., Assess MMR vaccination induced reactogenicity after MMR‐0 and MMR‐1 as an indication for vaccine responsiveness., Serum binding IgG antibody concentrations against measles, mumps and rubella prior to and 4 weeks post MMR-0 and prior to, 4 weeks post and 1 year post MMR-1 in MMR-0 immunised children and a control group., Immune cell phenotype and inflammation biomarkers (TruCount analysis) and immune biomarker (immune response and inflammation Olink panel) prior to and 1 week post primary MMR immunisation (MMR-0 for the MMR-0 immunised children and MMR-1 for the control group).

Source: https://euclinicaltrials.eu/ctis-public/view/2024-513395-18-00